EU clinical trial 2024-512873-29-00: Efficacy of combined treatment by autologous cell therapy and percutaneous transluminal angioplasty (PTA) versus the treatment by isolated PTA in diabetic patients with chronic limb-threatening ischemia
Protocol code: BMMNC_PTA_003
Sponsor: Institute For Clinical And Experimental Medicine (Hospital/Clinic/Other health care facility). Phase: Therapeutic exploratory (Phase II). Countries: Czechia (authorised, recruitment pending).
Therapeutic area(s): Diseases [C] - Digestive System Diseases [C06]
Gender: Female, Male. Age: 18-64 years, 65+ years. Enrolment: 110.
Status: Authorised, recruitment pending. Decision date: 2025-02-25. Results received: No. Last updated: 2025-02-25.

Condition(s): chronic limb-threatening ischemia, diabetic foot ulcers
Product: Suspension of autologous mononuclear cells separated from bone marrow aspirate

Primary endpoint: rate of major amputation, wound healing, TcPO2
Endpoint(s): other ischemia parameteres – ABI, laser doppler flowmetry, magnetic resonance spectroscopy; optional: microbiopsy of the muscle of the foot, other clinical effect – pain, safety: adverse events – expected and unexpected, assessment of quality of life (standardized questionnaires)

Source: https://euclinicaltrials.eu/ctis-public/view/2024-512873-29-00